EU clinical trial 2024-511837-37-00: A Phase 2 Study Evaluating the Efficacy, Safety, Tolerability, and Pharmacokinetics of Tarlatamab in Subjects with Relapsed/Refractory Small Cell Lung Cancer After Two or More Prior Lines of Treatment (DeLLphi-301).
Protocol code: 20200491
Sponsor: Amgen Inc. (Pharmaceutical company). Phase: Therapeutic exploratory (Phase II). Countries: Belgium (ongoing, recruitment ended), Denmark (ended), Italy (ongoing, recruitment ended), Austria (ongoing, recruitment ended), Greece (ongoing, recruitment ended), Spain (ongoing, recruitment ended), Poland (ongoing, recruitment ended), France (ongoing, recruitment ended), Germany (ongoing, recruitment ended).
Therapeutic area(s): Diseases [C] - Neoplasms [C04]
Gender: Female, Male. Age: 18-64 years, 65+ years. Enrolment: 113.
Start date (EU): 2021-12-21. Decision date: 2024-10-09. Results received: No. Last updated: 2026-06-19.
Decision dates by country: AT: 2024-10-14, FR: 2024-10-10, DK: 2024-10-10, IT: 2024-10-14, ES: 2024-10-10, PL: 2024-10-16, BE: 2024-10-09, DE: 2024-10-11, GR: 2024-11-26

Condition(s): Relapsed/Refractory Small Cell Lung Cancer
Product: SILTUXIMAB, TARLATAMAB, Tarlatamab, Tarlatamab

Primary endpoint: Part 1 only - objective response (OR) (complete response [CR] and partial response [PR]) •incidence of treatment-emergent adverse events (TEAEs) •serum concentrations of Tarlatamab, Part 1 and 2 - OR (CR and PR), Part 3 - Incidence of TEAEs
Endpoint(s): duration of response (DOR), disease control (DC), duration of DC, progression-free survival (PFS), DOR, overall survival (OS), incidence of TEAEs, serum concentrations of Tarlatamab, incidence of anti-Tarlatamab antibody formation

Source: https://euclinicaltrials.eu/ctis-public/view/2024-511837-37-00